EU clinical trial 2023-509929-51-00: Single and multiple ascending dose of ZP9830 in healthy participants
Protocol code: ZP9830-23005
Sponsor: Zealand Pharma A/S (Pharmaceutical company). Phase: Human Pharmacology (Phase I)- First administration to humans. Countries: Netherlands (ongoing, recruiting).
Therapeutic area(s): Diseases [C] - Immune System Diseases [C20]
Gender: Female, Male. Age: 18-64 years. Enrolment: 134.
Status: Ongoing, recruiting. Start date (EU): 2026-02-10. Decision date: 2024-10-28. Results received: No. Last updated: 2026-07-14.

Condition(s): Autoimmune diseases

Source: https://euclinicaltrials.eu/ctis-public/view/2023-509929-51-00